EU clinical trial 2024-515114-41-00: Phase 1/2 study evaluating genetically modified autologous T cells expressing a T-cell receptor recognizing a cancer/germline antigen as monotherapy or in combination with nivolumab in patients with recurrent and/or refractory solid tumors (ACTengine® IMA203-101)
Protocol code: IMA203-101
Sponsor: Immatics US Inc. (Pharmaceutical company). Phase: Phase I and Phase II (Integrated)- First administration to humans. Countries: Germany (ongoing, recruiting).
Therapeutic area(s): Diseases [C] - Neoplasms [C04]
Gender: Female, Male. Age: 18-64 years, 65+ years. Enrolment: 272.
Status: Ongoing, recruiting. Start date (EU): 2020-08-10. Decision date: 2024-08-27. Results received: No. Last updated: 2026-05-13.

Condition(s): Solid tumors
Product: IMA203, IMA203CD8, OPDIVO 10 mg/mL concentrate for solution for infusion.

Primary endpoint: Treatment-emergent adverse events (TEAEs) (Phase I/II), Adverse Events of special interest (AESIs) (Phase I/II), Serious TEAEs (Phase I/II), Number of patients with dose-limiting toxicities (Phase I), Objective response rate based on best overall response of complete response and partial response centrally assessed using RECIST 1.1 (Phase II)

Source: https://euclinicaltrials.eu/ctis-public/view/2024-515114-41-00